EU clinical trial 2024-517520-19-00: Phase II-III study to assess the efficacy and safety of sublingual immunotherapy in patients suffering from birch pollen allergy
Protocol code: SL-3P2A
Sponsor: ROXALL Medizin GmbH (Pharmaceutical company). Phase: Phase II and Phase III (Integrated). Countries: Germany (ongoing, recruitment ended).
Therapeutic area(s): Diseases [C] - Immune System Diseases [C20]
Gender: Female, Male. Age: 18-64 years. Enrolment: 30.
Status: Ongoing, recruitment ended. Start date (EU): 2025-09-01. Decision date: 2025-05-27. Results received: No. Last updated: 2025-05-27.

Condition(s): Patients with moderate-to-severe allergic rhinitis / rhinoconjunctivitis due to birch pollen for at least two years according to the Allergic Rhinitis and its Impact on Asthma (ARIA) guideline (Bousquet et al., 2008)
Product: Placebo preparation for sublingual use with appearance, smell, taste and excipients identical to verum, but without the active substance, i. e. allergen extract., SLI-RX-BET LOW dose, SLI-RX-BET MID dose, SLI-RX-BET HIGH dose

Primary endpoint: The primary (efficacy) endpoint is defined as the absolute differences in mean CSMS (Combined Symptom and Medication Score) during Peak Birch Pollen Period (PBPP) of each active treatment group compared with placebo treatment group.
Endpoint(s): Absolute and relative differences in mean CSMS during the Birch Pollen Season (BPS) between active and placebo treatment groups., Absolute and relative differences in mean dSS during PBPP and BPS., bsolute and relative differences in the 6 mean individual symptom scores (4 nasal and 2 ocular) during PBPP and BPS., Absolute and relative differences in mean dMS during PBPP and BPS., Global Rhinoconjunctivitis Discomfort with a 10.0-point Visual Analogue Scale (VAS)., Change in Rhinoconjunctivitis quality of life questionnaire (RQLQ) between active and placebo treatment groups comparing basal and post-treatment scoring., Well and severe days: A well day is defined as a day without administration of any rescue medication (dMS = 0) and with dSS < 0.34 (range 0-3). A severe day is defined (acc. to Pfaar et al., 2014) as a day with a single score = 3 in any of the six symptoms. Percentages of well and severe days will be calculated for each subject as the number of well or severe days in the PBPP and BPS in relation to the number of days comprising both periods., Symptom-free days during PBPP and PBP are defined as the days with absence of symptoms, (dSS = 0), and without administration of any rescue medication (dMS = 0), expressed as percentage of days during the PBPP and BPS., tNPT titrated Nasal Provocation Test: To assess the efficacy of each dose of SLI-RX-BET compared to placebo. Defined as percentage of patients with an increased dosing step and the change in number of dosing steps needed to provoke a positive response in the titrated nasal provocation test (tNPT) post-treatment compared with pre-treatment (i. e. any improvement) in each of the four study groups.This is based on the change of the response to nasal provocation (tNPT), To analyse the safety and tolerability of each dose of SLI-RX-BET compared to placebo by Treatment-Emergent Adverse Drug Reactions (TEADR) and patients affected with TEADRs in each group.

Source: https://euclinicaltrials.eu/ctis-public/view/2024-517520-19-00